EU clinical trial 2025-524570-41-00: A clinical trial of MK-6916 in healthy participants (MK-6916-010)
Protocol code: MK-6916-010
Sponsor: Merck Sharp & Dohme LLC (Pharmaceutical company). Phase: Human Pharmacology (Phase I)- Other. Countries: Belgium (ongoing, recruiting).
Therapeutic area(s): Diseases [C] - Nervous System Diseases [C10]
Gender: Female, Male. Age: 18-64 years. Enrolment: 54.
Status: Ongoing, recruiting. Start date (EU): 2026-03-16. Decision date: 2026-03-02. Results received: No. Last updated: 2026-04-30.

Condition(s): Acute and Chronic pain

Source: https://euclinicaltrials.eu/ctis-public/view/2025-524570-41-00